EU clinical trial 2024-512171-12-00: A Phase 2, Open-Label Extension Study to Assess the Safety and Efficacy of GLM101 Administered Intravenously to Participants with PMM2-CDG
Protocol code: GLM101-007
Sponsor: Glycomine Inc. (Pharmaceutical company). Phase: Therapeutic exploratory (Phase II). Countries: Spain (ongoing, recruiting), Portugal (ongoing, recruiting), Czechia (authorised, recruitment pending), Italy (authorised, recruitment pending), Germany (authorised, recruitment pending), France (authorised, recruitment pending).
Therapeutic area(s): Diseases [C] - Nutritional and Metabolic Diseases [C18]
Gender: Female, Male. Age: 0-17 years, 18-64 years, 65+ years. Enrolment: 63.
Start date (EU): 2024-09-27. Decision date: 2024-06-21. Results received: No. Last updated: 2026-07-27.
Decision dates by country: PT: 2026-05-12, CZ: 2026-06-16, IT: 2026-06-11, ES: 2024-09-05, DE: 2026-07-09, FR: 2026-07-27

Condition(s): PMM2-CDG
Product: GLM101, GLM101

Primary endpoint: Collection of the safety information from the collection of Side effects (or Adverse Events), deaths, and stopping the study due to side effects; Tests from blood and urine (hematology, chemistry, and urinalysis) (compared to before treatment with GLM101); ECG (heart tracings), vital signs (blood pressure, heart rate, and body temperature), and physical exam changes (compared to before treatment with GLM101)
Endpoint(s): Changes in International Co-operative Ataxia Rating Scale, ICARS (evaluated every 3-6 months, compared to before treatment with GLM101), The amount of Mannose-1-Phosphate (the sugar contained in a lipid bubble, which together make up GLM101) in blood (evaluated at Month 6)

Source: https://euclinicaltrials.eu/ctis-public/view/2024-512171-12-00